EU clinical trial 2022-501152-28-00: A randomized, open-label, phase II trial comparing neoadjuvant endocrine therapy in combination with trastuzumab, pertuzumab +/- the PI3K inhibitor inavolisib in patients with HER2-positive, HR-positive, PIK3CA mutant early breast cancer - GeparPiPPa
Protocol code: GBG 105
Sponsor: GBG Forschungs GmbH (Laboratory/Research/Testing facility). Phase: Therapeutic exploratory (Phase II). Countries: Germany (ongoing, recruiting), Belgium (ended), Italy (ongoing, recruiting), Spain (ongoing, recruiting), Romania (ongoing, recruiting), Slovakia (authorised, recruiting), Poland (authorised, recruiting).
Therapeutic area(s): Diseases [C] - Neoplasms [C04]
Gender: Female, Male. Age: 18-64 years, 65+ years. Enrolment: 195.
Start date (EU): 2022-12-21. Decision date: 2023-07-21. Results received: No. Last updated: 2026-08-07.
Decision dates by country: BE: 2024-05-08, PL: 2025-10-10, RO: 2025-09-08, IT: 2024-05-15, SK: 2025-09-11, DE: 2023-07-27, ES: 2025-02-28

Condition(s): Breast Cancer
Product: INAVOLISIB, Phesgo 600 mg/600 mg solution for injection, INAVOLISIB, Phesgo 1200 mg/600 mg solution for injection

Primary endpoint: Pathological complete response (ypT0/is ypN0) is defined as no microscopic evidence of residual invasive tumor cells in all resected specimens of the breast and axilla.
Endpoint(s): ypT0 ypN0 is defined as no microscopic evidence of residual invasive or non-invasive viable tumor cells in all resected specimens of the breast and axilla; ypT0 ypN0/+ is defined as no microscopic evidence of residual invasive or non-invasive viable tumor cells in all resected specimens of the breast; ypT0/Tis ypN0/+ is defined as no microscopic evidence of residual invasive viable tumor cells in all resected specimens of the breast;, Clinical (c) and imaging (i) response will be assessed every 2nd cycle and before surgery by physical examination and imaging tests, Breast conservation is defined as tumorectomy, segmentectomy or quadrantectomy as a most radical surgery, Tolerability and safety analyses include assessment of patients whose treatment had to be dose reduced, delayed or permanently stopped, Survival endpoints are defined as the time period between randomization and first event and will be analyzed after the end of the study by referring to data from GBG´s registries.

Source: https://euclinicaltrials.eu/ctis-public/view/2022-501152-28-00